EU clinical trial 2024-515709-24-00: A single-arm, open-label, Phase III trial to evaluate the safety and tolerability of intra-articular injections of RTX-GRT7039 in subjects with moderate to severe pain associated with osteoarthritis of the knee.
Protocol code: KF7039-03
Sponsor: Gruenenthal GmbH (Pharmaceutical company). Phase: Therapeutic confirmatory (Phase III). Countries: Romania (ended), Bulgaria (ended), Poland (ended).
Therapeutic area(s): Diseases [C] - Musculoskeletal Diseases [C05]
Gender: Female, Male. Age: 18-64 years, 65+ years. Enrolment: 511.
Status: Ended. Start date (EU): 2022-07-26. End date (EU): 2025-03-28. End date: 2025-05-15. Decision date: 2024-11-14. Results received: Yes. Last updated: 2025-02-28.
Decision dates by country: RO: 2024-12-03, PL: 2024-11-18, BG: 2024-11-14

Condition(s): Moderate to severe pain associated with Osteoarthritis of the knee
Product: RTX-GRT7039, Naropin® 5 mg/ml Injektionslösung

Primary endpoint: Incidence of treatment-emergent adverse events (TEAEs). Incidence of TEAEs leading to discontinuation.
Endpoint(s): Incidence of TEAEs representing structural changes of the knee joint as visualized by the imaging methods (X-ray and/or magnetic resonance imaging [MRI])., Change in the Western Ontario and McMaster Universities Osteoarthritis Index (WOMAC) physical function and pain subscale score for the index and the non-index (where applicable) knee., Change in QoL as assessed by questionnaires EQ-5D-5L and SF-36.

Source: https://euclinicaltrials.eu/ctis-public/view/2024-515709-24-00